EU clinical trial 2023-509930-21-00: PHARMACOKINETICS OF CEFEPIME AFTER INTRAPERITONEAL ADMINISTRATION VIA CYCLER-THERAPY IN APD PATIENTS WITHOUT PERITONITIS
Protocol code: 2
Sponsor: Noe LGA Gesundheit Region Mitte GmbH (Hospital/Clinic/Other health care facility). Phase: Therapeutic use (Phase IV). Countries: Austria (ended).
Therapeutic area(s): Phenomena and Processes [G] - Chemical Phenomena [G02]; Analytical, Diagnostic and Therapeutic Techniques and Equipment [E] - Therapeutics [E02]; Diseases [C] - Bacterial Infections and Mycoses [C01]
Gender: Female, Male. Age: 18-64 years, 65+ years. Enrolment: 8.
Status: Ended. Start date (EU): 2024-05-01. End date (EU): 2025-10-30. Decision date: 2024-04-15. Results received: No. Last updated: 2024-08-05.

Condition(s): CKD 5, Peritoneal Dialysis
Product: Cefepim-MIP 1 g Pulver zur Herstellung einer Injektions- / Infusionslösung

Primary endpoint: AUC, Cmax, Half-life (t1/2), Time to reach maximum drug concentration (tmax)
Endpoint(s): Ratios of AUC and Cmax of different compartments, Time above the minimal inhibitory concentration T>MIC, Ratio of AUC from 0 to 24 hours (AUC 0-24)/MIC

Source: https://euclinicaltrials.eu/ctis-public/view/2023-509930-21-00